EU clinical trial 2022-502518-98-00: B7981080 - A PHASE 3 RANDOMIZED, DOUBLE-BLIND, 52-WEEK PLACEBOCONTROLLED MULTI-CENTER STUDY WITH A DOUBLE-BLIND 52-WEEK EXTENSION PERIOD WITH RANDOMIZED DOSE UP/DOSE DOWN TITRATION INVESTIGATING THE EFFICACY, SAFETY, AND TOLERABILITY OF RITLECITINIB IN ADULT PARTICIPANTS WITH NONSEGMENTAL VITILIGO
Protocol code: B7981080
Sponsor: Pfizer Inc. (Pharmaceutical company). Phase: Therapeutic confirmatory (Phase III). Countries: Germany (ongoing, recruitment ended), Italy (ongoing, recruitment ended), Bulgaria (ongoing, recruitment ended), Slovakia (ongoing, recruitment ended), Poland (ongoing, recruitment ended), Hungary (ongoing, recruitment ended), Belgium (ongoing, recruitment ended), Spain (ongoing, recruitment ended).
Therapeutic area(s): Diseases [C] - Skin and Connective Tissue Diseases [C17]; Diseases [C] - Immune System Diseases [C20]
Gender: Female, Male. Age: 18-64 years, 65+ years. Enrolment: 355.
Status: Ongoing, recruitment ended. Start date (EU): 2024-04-26. Decision date: 2024-03-25. Results received: No. Last updated: 2026-05-25.
Decision dates by country: DE: 2024-03-26, BE: 2024-03-25, IT: 2024-03-27, PL: 2024-04-02, HU: 2024-05-07, BG: 2024-03-29, ES: 2024-04-01, SK: 2024-03-25

Condition(s): nonsegmental vitiligo
Product: Ritlecitinib Tosilate, Placebo for PF-06651600-15, 100 mg, Placebo for PF-06651600-15, 50 mg, Ritlecitinib tosilate, DEXAMETHASONE

Primary endpoint: Part Ia: Response based on F-VASI75 (defined as at least 75% improvement in Facial Vitiligo Area Scoring Index [F-VASI] from BL) at Week 52a, Part Ia: Incidence of treatment-emergent adverse events (TEAEs), serious adverse events (SAEs), and adverse events (AEs) leading to discontinuation, Part Ia: Incidence of clinically significant laboratory abnormalities, Part Ib: Incidence of TEAEs, SAEs, and AEs leading to discontinuation, Part Ib: Incidence of clinically significant laboratory abnormalities, Part II: Incidence of TEAEs, SAEs, and AEs leading to discontinuation, Part II: Incidence of clinically significant laboratory abnormalities., Part Ia: Response based on T-VASI50 at all time points in the SoA except for those included as primary and key secondary endpointa
Endpoint(s): Part Ia: Response based on T-VASI50 at Weeks 24, 36, and 52a, Part Ia: Response based on PGIC-F (defined as at least “moderately better” reported change in severity of vitiligo on the face from baseline [BL]) at Weeks 36 and 52a, Part Ia: Response based on PGIC-V (defined as at least “moderately better” reported change in severity of total body vitiligo from BL) at Weeks 36 and 52a, Part Ia: Response based on improvement in PGIS-Fb at Weeks 36 and 52a, Part Ia: Response based on improvement in PGIS-Vc at Weeks 36 and 52a, Part Ia: Response based on F-VASI75 at Weeks 24 and 36a, Part Ia: Response based on stabilization of disease at all time points after Week 8 in the Schedule of Activities (SoA), Part Ia: Response based on F-VASI75 at all time points in the SoA except for those included as primary and key secondary endpointsa, Part Ia: Response based on T-VASI75 at all time points in the SoA except for that included as a primary endpointa, Part Ia: Response based on sustained improvement in TVASI (defined as maintenance of ≥T-VASI50 from Week 36 to Week 52), Part Ia: Response based on sustained improvement in FVASI (defined as maintenance of ≥F-VASI75 from Week 36 to 52), Part Ia: Time to rescue medication use, Part Ia: Percent change from baseline (CFB) in F-VASI at all time points in the SoA, Part Ia: Percent CFB in T-VASI at all time points in the SoA, Part Ia: Response based on T-VASI90 (defined as at least 90% improvement in T-VASI from BL) at all time points in the SoA, Part Ia: Response based on T-VASI100 (defined as 100% improvement in T-VASI from BL) at all time points in the SoA, Part Ia: Response based on F-VASI50 (defined as at least 50% improvement in F-VASI from BL) at all time points in the SoA, Part Ia: Response based on F-VASI75 at all time points in the SoA unless included as primary or secondary endpoints, Part Ia: Response based on F-VASI90 (defined as at least 90% improvement in F-VASI from BL) at all time points in the SoAa, Part Ia: Response based on F-VASI100 (defined as 100% improvement in F-VASI from BL) at all time points in the SoA, Part Ia: Response based on improvement in PGIS-Fe at Week 36 unless included as key secondary endpoint, Part Ia: Response based on improvement in PGIS-Vf at Week 36 unless included as key secondary endpoint, Part Ia: Response based on PGIC-F (defined as at least “moderately better” reported change in facial vitiligo from BL) at Weeks 36 and 52 unless included as key secondary endpoint, Part Ia: Response based on PGIC-V (defined as at least “moderately better” reported change in total body vitiligo from BL) at Weeks 36 and 52 unless included as key secondary endpoint, Part Ia: CFB in Dermatology Life Quality Index (DLQI) at Week 52, Part Ia: CFB in the Hospital Anxiety and Depression Scale (HADS) depression subscale at Week 52, Part Ia: CFB in the HADS anxiety subscale at Week 52, Part Ia: Response based on a ‘normal’ subscale score indicative of an absence of depression at Week 52 (in participants with BL HADS subscale scores indicative of depression), Part Ia: Response based on a ‘normal’ subscale score indicative of an absence of anxiety at Week 52 (in participants with BL HADS subscale scores indicative of anxiety), Part Ia: Response based on T-VASI50 at all time points in the SoA except for those included as primary and key secondary endpointa, Part Ib: Response based on T-VASI75 (relative to BL) at all time points in the SoA, Part Ib: Response based on F-VASI75 (relative to BL) at all time points in the SoA, Part Ib: Response based on T-VASI50 (relative to BL) at all time points in the SoA, Part Ib: Response based on stabilization of disease at all time points after Week 60, Part Ib: Response based on F-VASI50 (relative to BL) at all time points in the SoA, Part Ib: Response based on F-VASI90 (relative to BL) at all time points in the SoA, Part Ib: Response based on T-VASI90 (relative to BL) at all time points in the SoA, Part Ib: Response based on T-VASI100 (relative to BL) at all time points in the SoA, Part Ib: Response based on improvement in PGIS-Fc at Week 104, Part Ib: Response based on improvement in PGIS-Vd at Week 104, Part Ib: Response based on scoring at least “moderately better” in facial vitiligo on PGIC-F at Week 104, Part Ib: Response based on scoring at least “moderately better” in total body vitiligo on PGIC-V at Week 104, Part II: Response based on T-VASI75 at all time points in the SoA, Part II: Response based on F-VASI75 at all time points in the SoA, Part II: Response based on T-VASI50 at all time points in the SoA, Part II: Response based on stabilization of disease at all time points after Week 8 in the SoA, Part II: Response based on sustained improvement in T- VASI, Part II: Response based on sustained improvement in F- VASI, Part II: Time to rescue medication use, Part II: Percent CFB in F-VASI at all time points in the SoA, Part II: Percent CFB in T-VASI at all time points in the SoA, Part II: Response based on T-VASI90 at all time points in the SoA, Part II: Response based on T-VASI100 at all time points in the SoA, Part II: Response based on F-VASI50 at all time points in the SoA, Part II: Response based on F-VASI90 at all time points in the SoA, Part II: Response based on F-VASI100 at all time points in the SoA, Part II: Response based on PGIC-F (defined as at least “moderately better” reported change in facial vitiligo from BL) at Weeks 36 and 52, Part II: Response based on PGIC-V (defined as at least “moderately better” reported change in total body vitiligo from BL) at Weeks 36 and 52, Part II: Response based on improvement in PGIS-Fb at Weeks 36 and 52, Part II: Response based on improvement in PGIS-Vc at Weeks 36 and 52, Part II: CFB in DLQI at Week 52, Part II: CFB in the HADS depression subscale at Week 52, Part II: CFB in the HADS anxiety subscale at Week 52, Part II: Response based on a ‘normal’ subscale score indicative of an absence of depression at Week 52 (in participants with BL HADS subscale scores indicative of depression), Part II: Response based on a ‘normal’ subscale score indicative of an absence of anxiety at Week 52 (in participants with BL HADS subscale scores indicative of anxiety)

Source: https://euclinicaltrials.eu/ctis-public/view/2022-502518-98-00